EU clinical trial 2022-501559-99-00: Platform randomised trial of treatments for COVID-19 in general practice
Protocol code: NL79504.068.21
Sponsor: Maastricht University. Phase: Therapeutic use (Phase IV). Countries: Netherlands (ended).
Therapeutic area(s): Diseases [C] - Virus Diseases [C02]
Gender: Female, Male. Age: 18-64 years, 65+ years. Enrolment: 682.
Status: Ended. Start date (EU): 2023-05-25. End date (EU): 2023-11-01. Decision date: 2023-03-06. Results received: No. Last updated: 2023-06-15.

Condition(s): Patients with symptomatic COVID-19 in the community and in primary care, who are at higher risk of a complicated illness course.
Product: MONTELUKAST SANDOZ 10 MG, FILMOMHULDE TABLETTEN

Primary endpoint: The primary endpoint is time to recovery from suspected COVID-19 infection within 28 days from randomisation, defined as the first instance that a participant reports feeling recovered. This will be measured by means of a daily diary, where the participant records the answer to the question ‘Do you feel fully recovered today? (i.e. symptoms associated with illness are no longer a problem)’ with either yes or no.
Endpoint(s): hospital admission, hospital assessment without admission, oxygen administration, Intensive Care Unit admission, duration of severe symptoms, sustained recovery, contacts with the health services, consumption of antibiotics, quality of life, daily rating of how well participant feels, safety, death, long term symptoms, post-COVID-19 functional status

Source: https://euclinicaltrials.eu/ctis-public/view/2022-501559-99-00